EU clinical trial 2023-507853-13-00: I7P-MC-DSAG - An Adaptive, Dose-Ranging, Phase 2 Study of Eltrekibart Given Alone or in Combination with Mirikizumab for the Treatment of Adult Patients with Moderately to Severely Active Ulcerative Colitis
Protocol code: I7P-MC-DSAG
Sponsor: Eli Lilly & Co. (Pharmaceutical company). Phase: Therapeutic exploratory (Phase II). Countries: Romania (temporarily halted), Spain (ongoing, recruitment ended), France (ongoing, recruitment ended), Denmark (not authorised), Italy (ongoing, recruitment ended), Greece (ongoing, recruitment ended), Belgium (ended), Czechia (ended), Hungary (temporarily halted), Ireland (ongoing, recruitment ended), Croatia (ongoing, recruiting), Germany (ongoing, recruitment ended), Poland (temporarily halted), Latvia (ended).
Therapeutic area(s): Diseases [C] - Digestive System Diseases [C06]
Gender: Female, Male. Age: 18-64 years, 65+ years. Enrolment: 605.
Start date (EU): 2025-02-25. Decision date: 2025-02-10. Results received: No. Last updated: 2026-04-01.
Decision dates by country: DK: 2025-02-13, BE: 2025-02-13, ES: 2025-02-11, CZ: 2025-02-11, HR: 2025-02-17, LV: 2025-02-12, GR: 2025-02-11, PL: 2025-02-17, HU: 2025-02-13, DE: 2025-02-14, IE: 2025-02-14, RO: 2025-02-14, FR: 2025-02-10, IT: 2025-02-14

Condition(s): Ulcerative Colitis
Product: Eltrekibart, 0.9% sodium chloride, Mirikizumab, Mirikizumab, Placebo for LY3074828 SC Injection, 1mL Prefilled Syringe

Primary endpoint: Proportion of participants who achieve clinical remission at Week 12

Source: https://euclinicaltrials.eu/ctis-public/view/2023-507853-13-00